EU clinical trial 2022-501804-80-00: A phase I, randomized, double-blind, placebo-controlled, four-way cross-over study to evaluate the analgesic effects of TRV045 in healthy adults
Protocol code: CP045-1002
Sponsor: Trevena Inc. (Pharmaceutical company). Phase: Human Pharmacology (Phase I)- Other. Countries: Netherlands (ended).
Therapeutic area(s): Diseases [C] - Nervous System Diseases [C10]
Gender: Female, Male. Age: 18-64 years. Enrolment: 24.
Status: Ended. Start date (EU): 2022-11-17. End date (EU): 2023-06-21. Decision date: 2022-11-15. Results received: Yes. Last updated: 2023-03-14.

Condition(s): Acute and chronic neuropathic pain secondary to diabetic peripheral neuropathy
Product: TRV045 placebo

Primary endpoint: Pharmacodynamic measurements with the UVB pain model
Endpoint(s): Pharmacokinetic endpoints, Safety and tolerability endpoints

Source: https://euclinicaltrials.eu/ctis-public/view/2022-501804-80-00